EU clinical trial 2024-515490-10-00: Continuing Treatment for Subjects Who Have Participated in a Prior Protocol Investigating Elotuzumab
Protocol code: CA204-185
Sponsor: Bristol Myers Squibb International Corporation (Pharmaceutical company). Phase: Therapeutic exploratory (Phase II). Countries: Romania (ended).
Therapeutic area(s): Diseases [C] - Neoplasms [C04]
Gender: Female, Male. Age: 18-64 years, 65+ years. Enrolment: 3.
Status: Ended. Start date (EU): 2021-04-12. End date (EU): 2026-02-23. End date: 2026-02-24. Decision date: 2024-08-14. Results received: No. Last updated: 2025-12-15.

Condition(s): Multiple Myeloma
Product: DEXAMETHASONE, DEXAMETHASONE, LENALIDOMIDE, Empliciti 400 mg powder for concentrate for solution for infusion., LENALIDOMIDE, LENALIDOMIDE, LENALIDOMIDE

Primary endpoint: The number of subjects who received at least one dose of elotuzumab or backbone therapy (other study drugs) and the duration of treatment will be collected.
Endpoint(s): In this study, all SAEs, Grade 5 AEs, AEs previously not reported, AEs leading to discontinuation will be collected. Adverse events and other symptoms will be graded according to the NCI Common Terminology Criteria for Adverse Events (CTCAE).

Source: https://euclinicaltrials.eu/ctis-public/view/2024-515490-10-00